EU clinical trial 2022-500587-35-01: Tranexamic acid for hyperacute spontaneous IntraCerebral Haemorrhage (TICH-3)
Protocol code: 21022
Sponsor: University Of Nottingham (Educational Institution). Phase: Therapeutic confirmatory (Phase III). Countries: Sweden (ongoing, recruiting), France (ongoing, recruiting), Denmark (ongoing, recruiting), Spain (ongoing, recruiting), Norway (ongoing, recruiting), Ireland (ongoing, recruiting), Italy (ongoing, recruiting), Finland (ongoing, recruiting).
Therapeutic area(s): Diseases [C] - Cardiovascular Diseases [C14]
Gender: Female, Male. Age: 18-64 years, 65+ years. Enrolment: 1961.
Status: Ongoing, recruiting. Start date (EU): 2023-07-06. Decision date: 2023-04-24. Results received: No. Last updated: 2026-03-18.
Decision dates by country: ES: 2023-04-25, FI: 2023-05-09, IE: 2023-05-12, NO: 2023-05-15, IT: 2023-04-24, FR: 2023-05-04, SE: 2023-04-27, DK: 2023-05-08

Condition(s): Stroke
Product: Cyklokapron 100mg/mL solution for injection/infusion, Sodium Chloride Injection BP 0.9% w/v

Primary endpoint: Primary outcome: Early death up to and including day 7 after ICH onset. Justification of primary outcome: Functional outcome using the mRS at 90 days is the recommended outcome measure after stroke. However, our hypothesis is that TXA improves outcome by stopping HE. HE is the most common cause of early death after ICH, TXA is a haemostatic therapy, therefore we believe early mortality ≤7 days is the most appropriate outcome for TICH-3.
Endpoint(s): To assess the effect of TXA on dependency 6 months after ICH

Source: https://euclinicaltrials.eu/ctis-public/view/2022-500587-35-01